EU clinical trial 2023-505125-14-00: A Randomized, Double-Blind, Placebo-Controlled Proof of Concept Study to Assess the Safety and Efficacy of Elezanumab in Acute Traumatic Cervical Spinal Cord Injury
Protocol code: M16-077
Sponsor: AbbVie Deutschland GmbH & Co. KG (Pharmaceutical company). Phase: Therapeutic exploratory (Phase II). Countries: Spain (ended).
Therapeutic area(s): Diseases [C] - Nervous System Diseases [C10]
Gender: Female, Male. Age: 18-64 years, 65+ years. Enrolment: 8.
Status: Ended. Start date (EU): 2020-07-24. End date (EU): 2026-01-26. End date: 2026-01-27. Decision date: 2023-11-08. Results received: No. Last updated: 2023-11-08.

Condition(s): Acute Traumatic Cervical Spinal Cord Injury
Product: Elezanumab, Placebo Solution for Injection or Infusion

Primary endpoint: The primary endpoint is the Upper Extremity Motor Score (UEMS), a subscore of the International Standards for Neurological Classification of Spinal Cord Injury (ISNCSCI, 2019 criteria) during the Treatment Period.
Endpoint(s): Spinal Cord Independence Measures (SCIM III) self-care score, UEMS change from baseline

Source: https://euclinicaltrials.eu/ctis-public/view/2023-505125-14-00